EU clinical trial 2023-505852-23-00: A Randomized, Controlled, Multicenter, Open-Label Study to Investigate the Efficacy and Safety of Adding Apalutamide to Radiotherapy and LHRH Agonist in High-Risk Patients With Hormone-Sensitive Prostate Cancer, Assessed by PSMA-PET, with an Observational Cohort
Protocol code: 56021927PCR3015
Sponsor: Janssen - Cilag International (Pharmaceutical company). Phase: Therapeutic confirmatory (Phase III). Countries: Italy (ongoing, recruitment ended), Portugal (ongoing, recruitment ended), Finland (ongoing, recruitment ended), Sweden (ongoing, recruitment ended), Spain (ongoing, recruitment ended), Denmark (ongoing, recruitment ended), Poland (ongoing, recruitment ended), Slovakia (ongoing, recruitment ended), Belgium (ongoing, recruitment ended), Austria (ongoing, recruitment ended), Hungary (ongoing, recruitment ended), Czechia (ongoing, recruitment ended), Germany (ongoing, recruitment ended).
Therapeutic area(s): Diseases [C] - Neoplasms [C04]
Gender: Male. Age: 18-64 years, 65+ years. Enrolment: 290.
Status: Ongoing, recruitment ended. Start date (EU): 2020-11-12. Decision date: 2024-02-21. Results received: No. Last updated: 2025-07-21.
Decision dates by country: BE: 2024-02-23, DK: 2024-02-21, CZ: 2024-02-23, IT: 2024-03-28, FI: 2024-02-22, HU: 2024-02-21, SK: 2024-02-21, PT: 2024-02-22, DE: 2024-02-23, AT: 2024-03-26, ES: 2024-02-22, PL: 2024-03-20, SE: 2024-02-22

Condition(s): High risk recurrent prostate cancer previously treated with radical prostatectomy
Product: TECHNETIUM (99MTC) COMPOUNDS, JNJ-56021927

Primary endpoint: PSMA-PET metastatic progression-free survival (ppMPFS): Defined as the time from randomization to the (scan) date of metastatic progression by PSMA PET (as determined by BICR) or death from any cause.

Source: https://euclinicaltrials.eu/ctis-public/view/2023-505852-23-00